EU clinical trial 2024-510572-20-00: Effect of ultrasound guided lateral infraclavicular brachial plexus block with Lidocaine or Ropivacaine for closed reduction of distal radius fractures - A randomized controlled non-inferiority trial
Sponsor: Nordsjaellands Hospital (Hospital/Clinic/Other health care facility). Phase: Therapeutic use (Phase IV). Countries: Denmark (ended).
Therapeutic area(s): Diseases [C] - Musculoskeletal Diseases [C05]; Analytical, Diagnostic and Therapeutic Techniques and Equipment [E] - Anesthesia and Analgesia [E03]
Gender: Female, Male. Age: 18-64 years, 65+ years. Enrolment: 63.
Status: Ended. Start date (EU): 2024-04-23. End date (EU): 2025-06-18. Decision date: 2024-04-04. Results received: No. Last updated: 2024-04-04.

Condition(s): Distal radius fractures with need of acute closed reduction
Product: Ropivacain Fresenius Kabi, Lidokain-adrenalin SAD, injektionsvæske, opløsning, Ropivacain Fresenius Kabi

Primary endpoint: The incidence of successful blockade 45 minutes after block performance

Source: https://euclinicaltrials.eu/ctis-public/view/2024-510572-20-00